EU clinical trial 2022-502050-14-00: A Phase 3, Multi-Center Study to Evaluate the Pharmacokinetics, Efficacy, and Safety of Risankizumab with Open-Label Induction, Randomized Double-Blind Maintenance, and Long-Term Extension Periods in Pediatric Subjects (2 to < 18 Years of Age) with Moderately to Severely Active Crohn's Disease
Protocol code: M16-194
Sponsor: Abbvie Deutschland GmbH & Co. KG (Pharmaceutical company). Phase: Therapeutic confirmatory (Phase III). Countries: Czechia (ended), Belgium (ongoing, recruiting), Sweden (authorised, recruiting), France (ongoing, recruiting), Bulgaria (ongoing, recruiting), Italy (ongoing, recruiting), Germany (ongoing, recruiting), Netherlands (ongoing, recruiting), Poland (ongoing, recruiting), Spain (ongoing, recruiting).
Therapeutic area(s): Diseases [C] - Immune System Diseases [C20]; Diseases [C] - Female Urogenital Diseases and Pregnancy Complications [C13]; Phenomena and Processes [G] - Digestive System and Oral Physiological Phenomena [G10]; Phenomena and Processes [G] - Immune system processes [G12]
Gender: Female, Male. Age: 0-17 years. Enrolment: 59.
Start date (EU): 2024-06-04. Decision date: 2024-01-16. Results received: No. Last updated: 2026-08-07.
Decision dates by country: SE: 2024-01-19, IT: 2024-01-19, ES: 2024-05-17, BG: 2024-01-22, NL: 2024-05-22, CZ: 2024-01-17, PL: 2024-05-20, FR: 2024-05-21, BE: 2024-01-16, DE: 2024-05-22

Condition(s): Crohn's disease
Product: ABBV-066 / Risankizumab, ABBV-066, Matching Placebo for 90 mg solution for injection, Matching placebo for 180 mg solution for injection, Risankizumab

Primary endpoint: PK Leading Cohort 1 and Cohort 2: Cmax, Tmax and AUCtau of risankizumab., Cohort 3: •Achievement of clinical remission per PCDAI at Week 64 (SS2). •Achievement of endoscopic response at Week 64 (SS2).
Endpoint(s): PK Leading Cohort 1 and Cohort 2: •Achievement of clinical remission per PCDAI at Week 64 (SS2). •Achievement of endoscopic response at Week 64 (SS2). •Achievement of clinical remission per PCDAI at Week 12 (SS1). •Achievement of endoscopic response at Week 12 (SS1). •Achievement of endoscopic remission at Week 12 (SS1). •Achievement of endoscopic remission at Week 64 (SS2). •Achievement of corticosteroid-free clinical remission per PCDAI at Week 64 (SS2)., Cohort 3: 1. Achievement of clinical remission per PCDAI at Week 12 (SS1). 2. Achievement of endoscopic response at Week 12 (SS1). 3. Achievement of endoscopic remission at Week 12 (SS1). 4. Achievement of endoscopic remission at Week 64 (SS2). 5. Achievement of corticosteroid-free clinical remission per PCDAI at Week 64 (SS2).

Source: https://euclinicaltrials.eu/ctis-public/view/2022-502050-14-00